EU clinical trial 2025-523815-12-00: "A Phase 3 Randomized Study Comparing JNJ-79635322 versus Teclistamab in Participants with Relapsed or Refractory Multiple Myeloma after 1 to 3 Prior Lines of Therapy, Including an Anti-CD38 Antibody and Lenalidomide"
Protocol code: 79635322MMY3002
Sponsor: Janssen Cilag International (Pharmaceutical company). Phase: Therapeutic confirmatory (Phase III). Countries: Poland (ongoing, recruiting), Spain (ongoing, recruiting), Czechia (ongoing, recruiting), France (authorised, recruiting), Italy (authorised, recruiting), Germany (authorised, recruiting), Greece (ongoing, recruiting).
Therapeutic area(s): Diseases [C] - Neoplasms [C04]
Gender: Female, Male. Age: 18-64 years, 65+ years. Enrolment: 206.
Start date (EU): 2026-07-06. Decision date: 2026-07-01. Results received: No. Last updated: 2026-07-06.
Decision dates by country: CZ: 2026-07-02, FR: 2026-07-01, DE: 2026-07-03, GR: 2026-07-02, IT: 2026-07-02, ES: 2026-07-03, PL: 2026-07-06

Condition(s): Relapsed or Refractory Multiple Myeloma
Product: teclistamab, JNJ-79635322, JNJ-79635322, teclistamab

Primary endpoint: Dual primary endpoints: CR or better, PFS

Source: https://euclinicaltrials.eu/ctis-public/view/2025-523815-12-00